EU clinical trial 2025-524594-16-00: A Phase I study to evaluate the safety and dosimetry of imaging with 68Ga-OncoACP3 in prostate cancer.
Protocol code: PH-ACP3GA-03/25
Sponsor: Philogen S.p.A. (Pharmaceutical company). Phase: Human Pharmacology (Phase I)- First administration to humans. Countries: Italy (ongoing, recruiting).
Therapeutic area(s): Diseases [C] - Neoplasms [C04]
Gender: Male. Age: 18-64 years, 65+ years. Enrolment: 20.
Status: Ongoing, recruiting. Start date (EU): 2026-05-12. Decision date: 2026-04-22. Results received: No. Last updated: 2026-04-22.

Condition(s): Patients with prostate cancer with: - suspected metastasis who are candidates for initial definitive therapy; - suspected recurrence based on elevated serum prostate-specific antigen (PSA) level (i.e., a progressive and confirmed serum PSA level > 0.2 ng/mL); - metastatic disease who might be candidates for treatment with 177Lu-labelled PSMA ligands

Source: https://euclinicaltrials.eu/ctis-public/view/2025-524594-16-00